EU clinical trial 2025-520581-22-00: Randomized, double-blind, placebo-controlled clinical trial to evaluate the optimal dose of Beltavac® with polymerized extract of grass pollen mixture in patients with allergic rhinoconjunctivitis associated or not with asthma.
Protocol code: PRO-RCT-GRAM-2025-01
Sponsor: Probelte Pharma S.L. (Pharmaceutical company). Phase: Therapeutic exploratory (Phase II). Countries: Spain (not authorised), Poland (not authorised).
Therapeutic area(s): Diseases [C] - Disorders of Environmental Origin [C21]; Diseases [C] - Eye Diseases [C11]
Gender: Female, Male. Age: 18-64 years, 65+ years. Enrolment: 120.
Status: Not authorised. Decision date: 2025-06-09. Results received: No. Last updated: 2025-06-16.
Decision dates by country: ES: 2025-06-09, PL: 2025-06-16

Condition(s): Allergic rhinoconjunctivitis caused due to exposure to pollen grasses
Product: PLACEBO, BELTAVAC polymerized grass mix, BELTAVAC polymerized grass mix, BELTAVAC polymerized grass mix

Primary endpoint: Proportion of patients whose reactivity to the Conjunctival Provocation Test (CPT) with grass extract decreases between baseline and visit 7. It means that the titrated 10 – fold step allergen concentration required to develop a positive response is at least one dose higher
Endpoint(s): Serum values of total IgE, grass specific IgE and IgG4 at baseline and final visit. Serum Phl p1 and Phl p5 specific IgE and IgG4 values at baseline and final visit (V0 and V7).

Source: https://euclinicaltrials.eu/ctis-public/view/2025-520581-22-00